EU clinical trial 2024-516262-11-00: Effects of intranasal oxytocin in the treatment of benzodiazepine withdrawal: A pilot randomized parallel group placebo-controlled trial
Protocol code: LBS180319
Sponsor: St. Olavs Hospital HF (Hospital/Clinic/Other health care facility). Phase: Therapeutic exploratory (Phase II). Countries: Norway (authorised, recruitment pending).
Therapeutic area(s): Psychiatry and Psychology [F] - Behavior and Behavior Mechanisms [F01]
Gender: Female, Male. Age: 18-64 years, 65+ years. Enrolment: 60.
Status: Authorised, recruitment pending. Decision date: 2024-11-07. Results received: No. Last updated: 2026-04-14.

Condition(s): Benzodiazepine dependence (F13.2)
Product: Natriumklorid Fresenius Kabi 9 mg/ml infusjonsvæske, oppløsning, Syntocinon 40 IE/ml neusspray, oplossing, OXYTOCIN CD PHARMA 6,7 mikrog/dose nesespray, oppløsning

Primary endpoint: The primary endpoint of the study is measuring BZD withdrawal symptoms to see if OT administered intranasally in addition to traditional dose tapering is more effective than BZD tapering and placebo. CIWA-B is a well-known and well-used 20-item questionnaire for BZD withdrawal symptoms where each item can be assigned a score from 0 to 4, i.e. the total score can range between 0-80 points. Based on previous studies a 3.5-point difference is considered clinically relevant.
Endpoint(s): Hamilton Anxiety and Depression Scale (HAD), Insomnia Severity Index (ISI) and actigraphy and Somnofy assessed akathisia and sleep.

Source: https://euclinicaltrials.eu/ctis-public/view/2024-516262-11-00